EU clinical trial 2024-515296-35-00: First-in-human interleukin-15-transpresenting Wilms’ tumor protein 1-targeting autologous dendritic cell vaccination in cancer patients
Protocol code: IL15 TransDC
Sponsor: Antwerp University Hospital (Hospital/Clinic/Other health care facility). Phase: Phase I and Phase II (Integrated)- First administration to humans. Countries: Belgium (ended).
Therapeutic area(s): Analytical, Diagnostic and Therapeutic Techniques and Equipment [E] - Therapeutics [E02]; Diseases [C] - Digestive System Diseases [C06]; Diseases [C] - Female Urogenital Diseases and Pregnancy Complications [C13]; Phenomena and Processes [G] - Immune system processes [G12]; Diseases [C] - Neoplasms [C04]
Gender: Female, Male. Age: 18-64 years, 65+ years. Enrolment: 10.
Status: Ended. Start date (EU): 2023-12-06. End date (EU): 2025-09-22. Decision date: 2024-11-04. Results received: No. Last updated: 2025-09-03.

Condition(s): Histologically or cytologically confirmed solid tumor of the pancreas, esophagus, liver or ovaries that is advanced, recurrent or progressing after at least first-line anti-cancer treatment, or for which no alternative standard therapy is available due to intolerance to or refusal of standard-of-care treatment
Product: WT1/IL15/IL15Ra mRNA DC

Primary endpoint: Feasibility based on (A) proportion of patients that had a successful leukapheresis, (B) proportion of patients that had successful vaccine production and meeting all quality control measurements and (C) proportion of patients who complete the study treatment schedule within the timeline schedule proposed in the study protocol, Safety, based on the occurrence of AEs and SAEs during IL-15-transpresenting WT1-targeting DC vaccine administration and during follow-up: (A) Proportions of patients in the safety population that experienced AEs, SAEs possibly, probably or definitely related to IL-15-transpresenting WT1-targeting DC vaccination, (B) Number and grade of AEs and SAEs in the safety population
Endpoint(s): Clinical efficacy: (A) best overall response (B) the duration of response for patients with OR (C) overall response rate (D) disease control rate (E) progression-free survival (F) overal survival, Immunogenicity, including, but not restricted to, functional WT1-specific T cell responses, Quality of life: (A) how patients experience the study therapy, (B) how patient-reported disease-related symptoms evolve over time, (C) how patient-reported quality of life evolves over time

Source: https://euclinicaltrials.eu/ctis-public/view/2024-515296-35-00